EU clinical trial 2023-507289-14-00: A PHASE II, RANDOMIZED, DOUBLE BLIND STUDY TO EVALUATE THE EFFICACY AND SAFETY OF AMY109 IN WOMEN WITH ENDOMETRIOSIS
Protocol code: AMY106EU
Sponsor: Chugai Pharmaceutical Co. Ltd. (Pharmaceutical company). Phase: Therapeutic exploratory (Phase II). Countries: Romania (ongoing, recruitment ended), Czechia (ongoing, recruitment ended), Poland (ongoing, recruitment ended).
Therapeutic area(s): Diseases [C] - Female Urogenital Diseases and Pregnancy Complications [C13]
Gender: Female. Age: 18-64 years. Enrolment: 80.
Status: Ongoing, recruitment ended. Start date (EU): 2024-10-21. Decision date: 2024-05-16. Results received: No. Last updated: 2026-05-06.
Decision dates by country: RO: 2024-05-17, CZ: 2024-05-16, PL: 2024-07-18

Condition(s): Endometriosis
Product: NAPROXEN SODIUM, DESOGESTREL, TRAMADOL HYDROCHLORIDE, IBUPROFEN, Placebo to match AMY109, Placebo to match desogestrel, Feanolla 75 microgram film-coated tablets, CODEINE PHOSPHATE, PARACETAMOL, NAPROXEN, AMY109

Primary endpoint: Changes of total score and stage in the revised American Society of Reproductive Medicine (r-ASRM) score assessed by laparoscopy from pre-treatment to post-treatment (only in the UK) Change in sum of long (i.e., the largest) diameters of endometriotic nodules assessed by MRI from pre-treatment to post-treatment

Source: https://euclinicaltrials.eu/ctis-public/view/2023-507289-14-00